EU clinical trial 2023-503618-64-00: A Randomized, Controlled, Open-label, Multicenter, Inferentially Seamless Phase 2/3 Study of Ibrutinib in Combination With Rituximab Versus Physician’s Choice of Lenalidomide Plus Rituximab or Bortezomib Plus Rituximab in Participants with Relapsed or Refractory Mantle Cell Lymphoma
Protocol code: 54179060MCL3004
Sponsor: Janssen - Cilag International (Pharmaceutical company). Phase: Therapeutic exploratory (Phase II). Countries: Czechia (ended), Spain (ended), Poland (ended).
Therapeutic area(s): Diseases [C] - Neoplasms [C04]
Gender: Female, Male. Age: 18-64 years, 65+ years. Enrolment: 7.
Status: Ended. Start date (EU): 2022-11-16. End date (EU): 2024-09-18. End date: 2024-09-26. Decision date: 2023-11-17. Results received: Yes. Last updated: 2024-04-24.
Decision dates by country: CZ: 2023-11-20, ES: 2023-11-17, PL: 2023-12-14

Condition(s): Relapsed/Refractory Mantle Cell Lymphoma
Product: Lenalidomide Accord 10 mg hard capsules, Lenalidomide Accord 20 mg hard capsules, Lenalidomide Accord 10 mg hard capsules, Lenalidomide Accord 5 mg hard capsules, Lenalidomide Accord 2.5 mg hard capsules, Lenalidomide Accord 5 mg hard capsules, IMBRUVICA 140 mg hard capsules, Lenalidomide Accord 20 mg hard capsules, VELCADE 3.5 mg powder for solution for injection, Lenalidomide Accord 15 mg hard capsules, Lenalidomide Accord 15 mg hard capsules, JNJ-54179060, Lenalidomide Accord 2.5 mg hard capsules, Ruxience 500 mg concentrate for solution for infusion

Source: https://euclinicaltrials.eu/ctis-public/view/2023-503618-64-00